EU clinical trial 2022-500988-12-00: Phase II, open label, single arm study of PembrolizumAb combiNeD with cisplatin or carbOplatin and etoposide in treatment naïve advanced meRkel cell cArcinoma (MCC) (PANDORA Trial).
Protocol code: PANDORA
Sponsor: Fondazione IRCCS Istituto Nazionale Dei Tumori (Patient organisation/association). Phase: Therapeutic exploratory (Phase II). Countries: Italy (ongoing, recruiting).
Therapeutic area(s): Diseases [C] - Skin and Connective Tissue Diseases [C17]
Gender: Female, Male. Age: 18-64 years, 65+ years. Enrolment: 35.
Status: Ongoing, recruiting. Start date (EU): 2023-12-18. Decision date: 2023-10-03. Results received: No. Last updated: 2026-06-10.

Condition(s): Advanced, naïve, Merkel cell carcinomas
Product: CISPLATINO SANDOZ, Etoposide Sandoz 20 mg/ml – Concentrato per soluzione per infusione, CARBOPLATINO TEVA 10 mg/ml concentrato per soluzione per infusione, KEYTRUDA 25 mg/mL concentrate for solution for infusion

Primary endpoint: ORR, that will be defined as the percentage of patients achieving complete response (CR) or partial response (PR) according to RECIST 1.1 criteria
Endpoint(s): Incidence of Serius Adverse Events (SAE), Incidence and severity of Immune-mediated Adverse Events (imAE), Incidence and severity of Adverse Events (AEs) according to NCI Common Terminology criteria Adverse Event (CTCAE), version 5.0, Overall Survival (OS) that will be measured from the date of starting therapy to the date of death by any cause, Progression Free Survival (PFS) that will be measured from the date of starting therapy to the date of disease progression or death., Duration of Response (DOR) that will be measured from the date of the first response to disease progression or death in those patients who achieved a CR o PR during study treatment

Source: https://euclinicaltrials.eu/ctis-public/view/2022-500988-12-00